EU clinical trial 2024-513390-50-00: STRATIFY; Near-infrared fluorescence molecular imaging of adalimumab-800CW to elucidate the drug distribution throughout inflamed tissue in inflammatory bowel disease and rheumatoid arthritis
Sponsor: Universitair Medisch Centrum Groningen (Hospital/Clinic/Other health care facility). Phase: Human Pharmacology (Phase I)- Other. Countries: Netherlands (ongoing, recruiting).
Therapeutic area(s): Diseases [C] - Immune System Diseases [C20]
Gender: Female, Male. Age: 18-64 years, 65+ years. Enrolment: 33.
Status: Ongoing, recruiting. Start date (EU): 2024-08-06. Decision date: 2024-10-03. Results received: No. Last updated: 2025-08-04.

Condition(s): Crohn's disease, Spondyloarthritis, Rheumatoid arthritis, Ulcerative colitis

Source: https://euclinicaltrials.eu/ctis-public/view/2024-513390-50-00